EU clinical trial 2024-517756-35-00: A study to learn about the study medicine called PF-08046032 in people with advanced cancers.
Protocol code: C5911001 - SGN-CD25V
Sponsor: Pfizer Inc. (Pharmaceutical company). Phase: Human Pharmacology (Phase I)- Other. Countries: Spain (ended).
Therapeutic area(s): Diseases [C] - Neoplasms [C04]
Gender: Female, Male. Age: 18-64 years, 65+ years. Enrolment: 33.
Status: Ended. Start date (EU): 2025-05-28. End date (EU): 2026-04-23. End date: 2026-04-24. Decision date: 2025-04-21. Results received: No. Last updated: 2025-12-12.

Condition(s): Advanced lymphomas (classic Hodgkin lymphoma [cHL], peripheral T cell lymphoma [PTCL], and diffuse large B cell lymphoma [DLBCL]), Solid tumors (eg, NSCLC, HNSCC, and melanoma)

Source: https://euclinicaltrials.eu/ctis-public/view/2024-517756-35-00